EU clinical trial 2023-503827-25-01: C5751002 - A randomized, phase 3, open-label study to evaluate sigvotatug vedotin compared with docetaxel in adult participants with previously treated non-small cell lung cancer (Be6A Lung-01)
Protocol code: SGNB6A-002
Sponsor: Seagen Inc. (Pharmaceutical company). Phase: Therapeutic confirmatory (Phase III). Countries: Norway (ongoing, recruitment ended), Belgium (ongoing, recruitment ended), Greece (ongoing, recruitment ended), Poland (ongoing, recruitment ended), Spain (ongoing, recruitment ended), Italy (ongoing, recruitment ended), Czechia (ongoing, recruitment ended), Romania (ongoing, recruitment ended), Netherlands (ongoing, recruitment ended), Germany (ongoing, recruitment ended), Hungary (ended), Austria (ended), France (ongoing, recruitment ended).
Therapeutic area(s): Diseases [C] - Neoplasms [C04]
Gender: Female, Male. Age: 18-64 years, 65+ years. Enrolment: 447.
Start date (EU): 2024-02-16. Decision date: 2023-12-15. Results received: No. Last updated: 2026-07-29.
Decision dates by country: GR: 2023-12-19, HU: 2023-12-20, BE: 2023-12-15, PL: 2023-12-18, AT: 2024-04-15, DE: 2023-12-20, RO: 2023-12-20, IT: 2023-12-18, NL: 2023-12-20, CZ: 2023-12-20, NO: 2023-12-15, ES: 2023-12-18, FR: 2024-03-12

Condition(s): Non-Small Cell Lung Cancer (NSCLC)
Product: DOCETAXEL

Primary endpoint: OS
Endpoint(s): PFS using Response Evaluation Criteria in Solid Tumors, Version 1.1 (RECIST v1.1) as assessed by BICR; PFS using RECIST v1.1 as assessed by investigator, Confirmed ORR using RECIST v1.1 as assessed by BICR; Confirmed ORR using RECIST v1.1 as assessed by investigator, DOR using RECIST v1.1 as assessed by BICR, DOR using RECIST v1.1 as assessed by investigator, Type, incidence, severity, seriousness, and relatedness of adverse events (AEs), Mean scores and change from baseline in the global health status/QoL combined score on the European Organization for Research and Treatment of Cancer Quality of Life Questionnaire-Core 30 (EORTC QLQ-C30), Mean scores and change from baseline in physical functioning and role functioning scores on the EORTC QLQ-C30, Mean scores and change from baseline in the dyspnea, cough, and chest pain scores on the European Organization for Research and Treatment of Cancer Quality of Life Questionnaire-Lung Cancer 13 (EORTC QLQ-LC13), TTD in the global health status/QoL combined score on the EORTC QLQ-C30, TTD in physical functioning and role functioning scores on the EORTC QLQ-C30, TTD in the dyspnea, cough, and chest pain scores on the EORTC QLQ-LC13

Source: https://euclinicaltrials.eu/ctis-public/view/2023-503827-25-01